EU clinical trial 2026-525291-26-00: A Randomized, Multicenter, Single-Blind, Parallel-Group Phase III Non-Inferiority Trial Comparing the Efficacy and Tolerability of a Fixed-Dose Combination of Metronidazole, Bismuth Oxide and Tetracycline HCl to Standard Concomitant Non-Bismuth Quadruple Therapy for First-Line Eradication of Helicobacter pylori in Adults.
Protocol code: HELICA/VER
Sponsor: Verisfield Single Member S.A. (Pharmaceutical company). Phase: Therapeutic confirmatory (Phase III). Countries: Greece (authorised, recruiting).
Therapeutic area(s): Diseases [C] - Bacterial Infections and Mycoses [C01]
Gender: Female, Male. Age: 18-64 years, 65+ years. Enrolment: 420.
Status: Authorised, recruiting. Start date (EU): 2026-07-07. Decision date: 2026-05-28. Results received: No. Last updated: 2026-07-02.

Condition(s): Helicobacter Pylori Infection
Product: KLARICID® 500 mg επικαλυμμένα με λεπτό υμένιο δισκία, Flagyl 500 mg κάψουλες, Amoxil 1 g διασπειρόμενα δισκία, Helides 40 mg γαστροανθεκτικά καψάκια, σκληρά, Helides 40 mg γαστροανθεκτικά καψάκια, σκληρά, Helicobacter Test INFAI 75 mg powder for oral solution, Metronidazole + Bismuth oxide + Tetracycline hydrochloride / Verisfield f.c. tablet

Primary endpoint: The primary endpoint is the successful clearance of the infection between the two groups, established by comparing the eradication rate in the microbiological intention-to-treat (mITT) set between the treatment arms. Successful clearance is defined as a negative Urea Breath Test (UBT) following the completion of the eradication treatment.
Endpoint(s): H. pylori eradication rate in the Per-Protocol (PP) population., Superiority: Statistical comparison of eradication rates (mITT and PP) to test for superiority of the Test arm over the Active Comparator., Compliance: The proportion of patients with adequate adherence (defined as consumption of ≥90% of prescribed units) based on unit counts and diary records., Incidence of Adverse Events (AEs): The proportion of patients reporting at least one AE., Tolerability: The proportion of patients who discontinued treatment prematurely due to AEs.

Source: https://euclinicaltrials.eu/ctis-public/view/2026-525291-26-00